EU clinical trial 2023-506779-82-00: I3Y-MC-JPBK: JUNIPER: A Randomized Phase 3 Study of Abemaciclib plus Best Supportive Care versus Erlotinib plus Best Supportive Care in Patients with Stage IV NSCLC with a Detectable KRAS Mutation Who Have Progressed After Platinum-Based Chemotherapy
Protocol code: I3Y-MC-JPBK
Sponsor: Eli Lilly & Co. (Pharmaceutical company). Phase: Therapeutic confirmatory (Phase III). Countries: France (ongoing, recruitment ended).
Therapeutic area(s): Diseases [C] - Neoplasms [C04]
Gender: Female, Male. Age: 18-64 years, 65+ years. Enrolment: 1.
Status: Ongoing, recruitment ended. Start date (EU): 2014-11-04. Decision date: 2023-10-12. Results received: No. Last updated: 2025-12-19.

Condition(s): Non Small Cell Lung Cancer
Product: ERLOTINIB

Primary endpoint: Overall Survival (OS). [ Time Frame: From Randomization Date to Date of Death from Any Cause (Up to 32 Months) ] OS defined as from randomization date to the date of death due to any cause. For each participant who is not known to have died as of the data-inclusion cutoff date for overall survival analysis, OS time was censored on the last date the participant is known to be alive.

Source: https://euclinicaltrials.eu/ctis-public/view/2023-506779-82-00